EU clinical trial 2024-516835-29-00: Fecal Microbiota Transplant (FMT) combined with Atezolizumab plus Bevacizumab in Patients with HepatoCellular Carcinoma who failed to respond to prior Immunotherapy – the FAB-HCC pilot study
Protocol code: FAB0001
Sponsor: Medical University Of Vienna (Educational Institution). Phase: Therapeutic exploratory (Phase II). Countries: Austria (ended).
Therapeutic area(s): Diseases [C] - Digestive System Diseases [C06]
Gender: Female, Male. Age: 18-64 years, 65+ years. Enrolment: 12.
Status: Ended. Start date (EU): 2023-08-04. End date (EU): 2025-03-17. Decision date: 2024-12-10. Results received: Yes. Last updated: 2024-12-10.

Condition(s): Hepatocellular Carcinoma
Product: Avastin 25 mg/ml concentrate for solution for infusion., Tecentriq 1 200 mg concentrate for solution for infusion

Primary endpoint: The primary endpoint will be analyzed using descriptive statistics. In detail, the incidence and severity of treatment-related adverse events determined according to National Cancer Institute (NCI) Common Terminology Criteria for Adverse Events (CTCAE) version 5.0 will be described.
Endpoint(s): Efficacy will be evaluated by the number (percentage) of study participants achieving complete response (CR), partial response (PR), stable disease (SD) or progressive disease (PD) as best radiological response evaluated according to mRECIST and RECIST v1.1 criteria. Objective response is defined as either complete or partial response, while disease control rate comprises complete/partial response as well as stable disease. Kaplan-Meier method will be used to calculate progression-free survival, Distribution of quality of life parameters will be assessed by plotting histograms. Baseline and follow-up values will be demonstrated as mean (+/- standard deviation) or median (IQR), as applicable. Changes of quality of life during the study period as assessed by EQ-5D-5L questionnaire will be evaluated using paired T-test or Wilcoxon signed rank test.

Source: https://euclinicaltrials.eu/ctis-public/view/2024-516835-29-00